EU clinical trial 2024-515953-52-00: PACIFICA Phase 3: A Randomized, Controlled Phase 3 Study of Pacritinib Versus Physician’s Choice in Patients with Primary Myelofibrosis, Post Polycythemia Vera Myelofibrosis, or Post Essential Thrombocythemia Myelofibrosis with Severe Thrombocytopenia (Platelet Counts <50,000/μL)
Protocol code: PAC303
Sponsor: Sobi Inc. (Pharmaceutical company). Phase: Therapeutic confirmatory (Phase III). Countries: Hungary (ongoing, recruitment ended), Czechia (ongoing, recruitment ended), Romania (ongoing, recruitment ended), Spain (ongoing, recruitment ended), Italy (ongoing, recruitment ended), Bulgaria (ongoing, recruitment ended), Poland (ongoing, recruitment ended), France (ongoing, recruitment ended).
Therapeutic area(s): Diseases [C] - Neoplasms [C04]; Diseases [C] - Cardiovascular Diseases [C14]
Gender: Female, Male. Age: 18-64 years, 65+ years. Enrolment: 207.
Status: Ongoing, recruitment ended. Start date (EU): 2020-07-24. Decision date: 2024-11-08. Results received: No. Last updated: 2026-06-08.
Decision dates by country: RO: 2024-11-27, FR: 2024-11-08, HU: 2024-11-08, CZ: 2024-11-11, IT: 2024-11-13, ES: 2024-11-12, BG: 2024-11-11, PL: 2024-11-24

Condition(s): Post-Essential Thrombocythaemia Myelofibrosis, Post-Polycythaemia Vera Myelofibrosis, Primary Myelofibrosis
Product: DANAZOL, Pacritinib, RUXOLITINIB, PREDNISOLONE, METHYLPREDNISOLONE, PREDNISONE, METHYLPREDNISOLONE, DEXAMETHASONE, HYDROXYCARBAMIDE

Primary endpoint: 1. Percentage of participants who achieve at least 35% reduction in spleen volume from baseline as measured by MRI (preferred) or CT scan at Week 24., 2. Percentage of participants with at least 50% reduction in TSS from baseline at Week 24 (as defined by the Myeloproliferative Neoplasm Symptom Assessment Form [MPN‐SAF TSS 2.0] excluding the “tiredness” component)
Endpoint(s): 1. Percentage of participants who self-assess as “very much improved” or “much improved” at Week 24, 2. Time from randomization to the date of death due to any cause, 3. Incidence and severity of TEAEs, including SAEs and deaths, as well as laboratory values and vital signs, including cardiac evaluations from the time of randomization until 30 days after completion of treatment with pacritinib and/or physician's choice therapy

Source: https://euclinicaltrials.eu/ctis-public/view/2024-515953-52-00